EU clinical trial 2023-508404-37-00: A Phase 1 Dose-escalation Study of UGN-301 in Patients With Recurrent Non-muscle Invasive Bladder Cancer (NMIBC)
Protocol code: UR001
Sponsor: Urogen Pharma Ltd. (Pharmaceutical company). Phase: Human Pharmacology (Phase I)- Other. Countries: Italy (ended), Spain (ended).
Therapeutic area(s): Diseases [C] - Neoplasms [C04]
Gender: Female, Male. Age: 18-64 years, 65+ years. Enrolment: 48.
Status: Ended. Start date (EU): 2022-10-26. End date (EU): 2025-12-15. End date: 2026-01-09. Decision date: 2024-07-11. Results received: No. Last updated: 2025-08-13.
Decision dates by country: IT: 2024-07-15, ES: 2024-07-11

Condition(s): Non-muscle Invasive Bladder Cancer

Source: https://euclinicaltrials.eu/ctis-public/view/2023-508404-37-00